EU clinical trial 2022-501992-15-00: A phase 1/2 multicenter open-label study to investigate treatment of hydroxyurea (HU) in combination with valproic acid (VPA) or 6- mercaptopurine (6-MP) in combination with VPA in patients with acute myeloid leukemia (AML) or high-risk myelodysplastic syndrome (HR-MDS) considered unfit for standard chemotherapy
Sponsor: Helse Bergen HF (Hospital/Clinic/Other health care facility). Phase: Phase I and Phase II (Integrated)- Other. Countries: Norway (ongoing, recruiting).
Therapeutic area(s): Diseases [C] - Neoplasms [C04]
Gender: Female, Male. Age: 18-64 years, 65+ years. Enrolment: 48.
Status: Ongoing, recruiting. Start date (EU): 2024-05-21. Decision date: 2023-05-08. Results received: No. Last updated: 2026-06-03.

Condition(s): Acute Myeloid Leukemia (AML)
Product: HYDROXYCARBAMIDE, VALPROIC ACID, MERCAPTOPURINE

Primary endpoint: Safety and tolerability assessed by monitoring the incidence, frequency and severity of AEs, including evaluation of the following: i. DLTs ii. Physical examinations iii. Clinical laboratory blood and urine samples, Determine clinical benefit (as defined by this protocol) in patients receiving hydroxyurea in combination with valproic acid, Determine clinical benefit* in patients receiving 6-mercaptopurine in combination with valproic acid, Baseline and longitudinal ECOG status of the patient (Eastern Cooperative Oncology Group)
Endpoint(s): (a) The percentage of patients with clinical benefit after 3 and 6 cycles in each arm ( A1, A2, B1, B2) (b) Overall response rate (ORR; defined as the percentage of patients with a response of CR, CRh, CRi, MLFS, PR or no response as assessed by ELN response criteria 2022) (c) Duration of clinical benefit (d) Time to progression (e) Overall Survival (OS), Usage of health-related quality of life questionnaires: i. EQ -5D-5L ii. SF-36, QLQ-C30 iii. NCI- PRO-CTCAE (b) Lower number of hospital admissions and blood-/platelet transfusions during and after study investigation compared to baseline.

Source: https://euclinicaltrials.eu/ctis-public/view/2022-501992-15-00